EU clinical trial 2024-516966-12-00: A randomized, placebo-controlled, parallel group, 72-week study to evaluate the efficacy and safety of VHB937 in participants with early Alzheimer’s Disease followed by an Extension
Protocol code: CVHB937A12201
Sponsor: Novartis Pharma AG (Pharmaceutical company). Phase: Therapeutic exploratory (Phase II). Countries: Netherlands (ongoing, recruiting), Germany (ongoing, recruiting), Italy (ongoing, recruiting), Poland (ongoing, recruiting), Spain (ongoing, recruiting), Czechia (ongoing, recruiting), France (ongoing, recruiting), Sweden (ongoing, recruiting).
Therapeutic area(s): Diseases [C] - Nervous System Diseases [C10]
Gender: Female, Male. Age: 18-64 years, 65+ years. Enrolment: 167.
Status: Ongoing, recruiting. Start date (EU): 2026-02-13. Decision date: 2025-08-04. Results received: No. Last updated: 2026-06-16.
Decision dates by country: NL: 2025-08-06, CZ: 2025-08-04, PL: 2025-08-04, SE: 2025-08-05, DE: 2025-08-05, IT: 2025-08-06, FR: 2025-08-06, ES: 2025-08-04

Condition(s): Alzheimer’s disease
Product: 00 mg/mL Concentrate for solution for infusion, VHB937

Primary endpoint: Change from Baseline to Week 72 in the Clinical Dementia Rating scale – Sum of Boxes (CDR-SB)
Endpoint(s): Incidence and severity of: ● Adverse events ● Safety findings from brain MRI (based on blinded independent central reading to assess abnormalities including ARIA events) ● Laboratory tests ● Vital signs ● ECG findings ● Suicidality assessment (Columbia Suicide Severity Rating Scale C-SSRS), Changes from Baseline in CDR-SB and ADAS-Cog14 over time until Week 72, Changes from Baseline in instrumental activities of daily living (iADL) on the ADCS-ADL scale over time until Week 72, Pharmacokinetics: determination of VHB937 concentrations in serum at selected timepoints Immunogenicity: determination of anti-VHB937 antibodies in serum at selected timepoints

Source: https://euclinicaltrials.eu/ctis-public/view/2024-516966-12-00